EU clinical trial 2023-506677-36-00: A Phase 1-2 multicenter study to evaluate the safety and tolerability of intravenous ATA-100, adeno-associated viral vector carrying the FKRP gene, in patients with FKRP-related limb-girdle muscular dystrophy (LGMDR9, formerly LGMD2I)
Protocol code: ATA-001-FKRP
Sponsor: Atamyo Therapeutics (Pharmaceutical company). Phase: Phase I and Phase II (Integrated)- First administration to humans. Countries: Denmark (ongoing, recruitment ended), France (ongoing, recruitment ended).
Therapeutic area(s): Diseases [C] - Musculoskeletal Diseases [C05]
Gender: Female, Male. Age: 0-17 years, 18-64 years, 65+ years. Enrolment: 20.
Status: Ongoing, recruitment ended. Start date (EU): 2022-07-18. Decision date: 2023-11-10. Results received: No. Last updated: 2026-06-09.
Decision dates by country: DK: 2023-11-10, FR: 2023-11-20

Condition(s): FKRP-related limb-girdle muscular dystrophy (LGMD R9)
Product: METHYLPREDNISOLONE, rAAV9-hFKRPco_miR-208a, PREDNISOLONE

Primary endpoint: Safety and tolerability of ATA-100, as measured by incidence of treatment emergent adverse events, incidence of serious adverse events, and incidence of clinically significant laboratory changes.
Endpoint(s): Change from baseline in muscular function tests (NSAD score, 10MWT, etc.) and pulmonary function test (FVC) at one year post-IMP administration, Change from baseline in muscle MRI parameters (fat fraction, T2 water content) at one year post-IMP administration, Change from baseline in other respiratory assessments (IC, MIP/MEP, SNIP) at one year post-IMP administration, Change from baseline in muscle biomarkers (histological features, biodistribution, transgene expression) at one year post-IMP administration, Change from baseline in patient reported outcome and quality-of-life assessment (gNMD, Activlim) at one year post-IMP administration, Change from baseline in biomarkers (creatine kinase, myomesin-3, circulating microRNA) at one year post-IMP administration

Source: https://euclinicaltrials.eu/ctis-public/view/2023-506677-36-00